EU clinical trial 2024-519660-40-00: A study comparing the new drug PG413 produced by Celon Pharma SA with the drug Eliquis available on the market in healthy volunteers.
Protocol code: 02API2024
Sponsor: Celon Pharma S.A. (Pharmaceutical company). Phase: Human Pharmacology (Phase I)- Bioequivalence Study. Countries: Poland (ended).
Therapeutic area(s): Diseases [C] - Cardiovascular Diseases [C14]
Gender: Female, Male. Age: 18-64 years. Enrolment: 38.
Status: Ended. Start date (EU): 2025-03-31. End date (EU): 2025-06-11. Decision date: 2025-03-27. Results received: No. Last updated: 2025-03-27.

Condition(s): Prevention of stroke and systemic embolism in adult patients with non-valvular atrial fibrillation (NVAF), with one or more risk factors, such as prior stroke or transient ischaemic attack (TIA); age≥ 75 years; hypertension; diabetes mellitus; symptomatic heart failure (NYHA Class ≥ II). Treatment of deep vein thrombosis (DVT) and pulmonary embolism (PE), and prevention of recurrent DVT and PE in adults.

Source: https://euclinicaltrials.eu/ctis-public/view/2024-519660-40-00